EU clinical trial 2024-511322-31-00: Effect of ALlopurinol in addition to hypothermia for hypoxicischemic Brain Injury on Neurocognitive Outcome
Protocol code: Albino
Sponsor: Universitaetsklinikum Tuebingen AöR (Hospital/Clinic/Other health care facility). Phase: Therapeutic confirmatory (Phase III). Countries: Germany (ended), Italy (ended), Norway (ended), Spain (ended), Finland (ended), Netherlands (ended), Austria (ended), Estonia (ended), Belgium (ended).
Therapeutic area(s): Diseases [C] - Congenital, Hereditary, and Neonatal Diseases and Abnormalities [C16]
Gender: Female, Male. Age: 0-17 years. Enrolment: 452.
Status: Ended. Start date (EU): 2018-03-26. End date (EU): 2026-04-21. End date: 2026-04-22. Decision date: 2024-09-10. Results received: No. Last updated: 2026-05-20.
Decision dates by country: BE: 2024-09-11, EE: 2024-09-16, DE: 2024-09-11, NL: 2024-09-13, AT: 2024-09-15, NO: 2024-09-10, IT: 2024-09-16, ES: 2024-09-12, FI: 2024-09-12

Condition(s): Brain injury termed “hypoxic-ischemic encephalopathy” (HIE) as a result of various events during labour and childbirth such as placental abruption, uterine rupture, umbilical cord complications, etc.)
Product: ACEPURIN, poeder voor infusievloeistof 1g/100 ml, MANNITOL

Primary endpoint: Death versus severe neurodevelopmental impairment versus survival without severe neurodevelopmental impairment at the age of two years
Endpoint(s): Death or neurodevelopmental impairment (NDI) The primary endpoint will be reconstituted as dichotomised composite secondary endpoint (survival without NDI versus Death or languagecomposite- score < 85 or cognitive-composite-score <85 or cerebral palsy present)., Incidence of CP Incidence of CP will be analyzed by Cochrane-Mantel-Haenzel- X²-Test., GMFCS-score GMFCS-Score for quantification of the effects of cerebral palsy and other motor impairments (adapted from Palisano et al. [Palisano Med Child Neurol 1997]) using the ALBINO-GMFCS-score sheet (separate document not part of this protocol) will be analysed. GMFCS-score consists of six categories., Motor-Composite-Score (Bayley III), Motor-Composite-Score dichotomised (Bayley III) The motor-composite-score will be dichotomised at the cut-off <85 versus ≥85, Cognitive-Composite-Score (cognitive subscale, Bayley III), Cognitive-Composite-Score dichotomised (cognitive subscale, Bayley III) The cognitive-composite-score will be dichotomised at the cut-off <85 versus ≥85, Language-Composite-Score (language subscale, Bayley III), Language-Composite-Score dichotomised (language subscale, Bayley III) The language-composite-score will be dichotomised at the cut-off <85 versus ≥85, Single Components of primary endpoint - Graph Single components and observed combinations of the primary endpoint (healthy, death, CP, language-composite-score <85, cognitivecomposite- score <85) will be displayed graphically stratified for the two treatment groups.

Source: https://euclinicaltrials.eu/ctis-public/view/2024-511322-31-00